EU clinical trial 2025-521035-37-00: A multicenter, multinational, randomized, double-blind, placebo-controlled Phase 3, induction study to evaluate the efficacy and safety of duvakitug in participants with moderately to severely active Ulcerative Colitis.
Protocol code: EFC18325
Sponsor: Sanofi-Aventis Recherche & Developpement (Pharmaceutical company). Phase: Therapeutic confirmatory (Phase III). Countries: Austria (ongoing, recruiting), France (ongoing, recruiting), Norway (ongoing, recruiting), Hungary (ongoing, recruiting), Bulgaria (ongoing, recruiting), Netherlands (ongoing, recruiting), Czechia (ongoing, recruiting), Slovakia (ongoing, recruiting), Germany (ongoing, recruiting), Lithuania (ongoing, recruiting), Greece (ongoing, recruiting), Belgium (ongoing, recruiting), Italy (ongoing, recruiting), Spain (ongoing, recruiting), Poland (ongoing, recruiting).
Therapeutic area(s): Diseases [C] - Immune System Diseases [C20]
Gender: Female, Male. Age: 0-17 years, 18-64 years, 65+ years. Enrolment: 499.
Status: Ongoing, recruiting. Start date (EU): 2026-03-02. Decision date: 2026-02-09. Results received: No. Last updated: 2026-07-08.
Decision dates by country: AT: 2026-02-09, BE: 2026-02-12, BG: 2026-02-13, FR: 2026-02-09, HU: 2026-02-13, LT: 2026-02-11, PL: 2026-02-16, NL: 2026-02-11, GR: 2026-02-11, SK: 2026-02-10, CZ: 2026-02-10, IT: 2026-02-11, NO: 2026-02-11, DE: 2026-02-10, ES: 2026-02-16

Condition(s): Immune system diseases
Product: Duvakitug, matched placebo for test product

Primary endpoint: Proportion of participants achieving clinical remission.
Endpoint(s): Proportion of participants who achieve endoscopic improvement., Proportion of participants achieving clinical response by modified Mayo Score (mMS)., Proportion of participants achieving histological endoscopic mucosal improvement., Change from baseline in PROMIS-Fatigue Short Form 7a T-score., Proportion of participants with symptomatic (SFS and RBS) remission, Proportion of participants with no bowel urgency, Proportion of participants reporting no nocturnal bowel movements, Proportion of participants with symptomatic (stool-frequency sub score [SFS] and = rectal bleeding sub score [RBS]) remission., Proportion of participants who achieve endoscopic remission., Proportion of participants with no abdominal pain by Numeric Rating Scale (NRS)., Change from baseline in Inflammatory Bowel Disease Questionnaire (IBDQ) total score., Proportion of participants with UC-related hospitalization, Proportion of participants achieving clinical remission and no steroid use., Incidence of Treatment-Emergent Adverse Events (TEAEs), Treatment- Emergent Adverse Events of Special Interest (TEAESIs), Treatment-Emergent Serious Adverse Events (TESAEs), and Treatment-Emergent Adverse Events (TEAEs) leading to permanent study intervention discontinuation., Serum concentration of duvakitug measured over time., Incidence of treatment-emergent Anti-Drug Antibodies (ADA) against duvakitug

Source: https://euclinicaltrials.eu/ctis-public/view/2025-521035-37-00